EU clinical trial 2024-518912-37-01: Phase II Prospective Multicenter Study of High-Dose Treosulfan/Melphalan as Consolidation Treatment in Newly Diagnosed High-Risk and Very High-Risk Ewing Sarcoma.
Protocol code: INES
Sponsor: Fondazione Santobono Pausilipon Onlus (Patient organisation/association). Phase: Therapeutic exploratory (Phase II). Countries: Italy (authorised, recruitment pending).
Therapeutic area(s): Diseases [C] - Neoplasms [C04]
Gender: Female, Male. Age: 0-17 years, 18-64 years. Enrolment: 60.
Status: Authorised, recruitment pending. Decision date: 2024-12-09. Results received: No. Last updated: 2026-02-09.

Condition(s): Ewing Sarcoma
Product: VINCRISTINE, MELPHALAN, DOXORUBICIN, CYCLOPHOSPHAMIDE, IFOSFAMIDE, Trecondi 1 g powder for solution for infusion, ETOPOSIDE, Trecondi 5 g powder for solution for infusion

Primary endpoint: • Frequency, duration, and severity of Adverse Effects (AEs) and Serious Adverse Effects (SAEs) according to CTCAE v. 5.0 • Event-Free Survival at 36 months defined as the time from the start of chemotherapy to disease progression, relapse, second malignancies, death from treatment-related complications, or the last follow-up
Endpoint(s): Overall Survival at 36 months defined as the time from the start of chemotherapy to death or the last follow-up

Source: https://euclinicaltrials.eu/ctis-public/view/2024-518912-37-01